EU clinical trial 2022-501417-31-01: A Phase 3, Randomized, Double-blind, Active-Comparator-Controlled Clinical Study of Adjuvant MK-7684A (Vibostolimab with Pembrolizumab) Versus Adjuvant Pembrolizumab in Participants with High-risk Stage II-IV Melanoma (KEYVIBE-010)
Protocol code: MK-7684A-010
Sponsor: Merck Sharp & Dohme LLC (Pharmaceutical company). Phase: Therapeutic confirmatory (Phase III). Countries: Austria (ended), France (ended), Spain (ended), Italy (ended), Belgium (ended), Sweden (ended), Germany (ended), Ireland (ended), Poland (ended).
Therapeutic area(s): Diseases [C] - Neoplasms [C04]
Gender: Female, Male. Age: 0-17 years, 18-64 years, 65+ years. Enrolment: 462.
Status: Ended. Start date (EU): 2023-08-01. End date (EU): 2025-09-04. End date: 2025-09-24. Decision date: 2023-07-24. Results received: No. Last updated: 2025-08-20.
Decision dates by country: SE: 2023-07-24, DE: 2023-07-25, AT: 2023-07-25, FR: 2023-07-25, PL: 2023-07-28, BE: 2023-07-24, IE: 2023-07-28, ES: 2023-07-25, IT: 2023-07-25

Condition(s): melanoma
Product: KEYTRUDA 25 mg/mL concentrate for solution for infusion, MK-7684A

Primary endpoint: Recurrence-Free Survival (RFS)
Endpoint(s): Distant Metastasis-Free Survival (DMFS), Overall Survival (OS), Number of Participants Who Experienced at Least One Adverse Event (AE), Number of Participants Who Discontinued Study Treatment Due to an AE, Change from Baseline in the European Organization for Research and Treatment of Cancer (EORTC)-Quality of Life Questionnaire-Core 30 (QLQ-C30) Global Health Status/Quality of Life (Items 29 and 30) Combined Score, Change from Baseline in the EORTC QLQ-C30 Physical Functioning (Items 1-5) Combined Score, Change from Baseline in the EORTC QLQ-C30 Role Functioning (Items 6 and 7) Combined Score

Source: https://euclinicaltrials.eu/ctis-public/view/2022-501417-31-01